EU clinical trial 2023-503609-12-00: Open label trial to evaluate the adhesion of an Esflurbiprofen Topical System (EFTS) in healthy volunteers
Protocol code: TK-254RX-0106
Sponsor: Teikoku Seiyaku Co. Ltd. (Pharmaceutical company). Phase: Human Pharmacology (Phase I)- Other. Countries: Germany (ended).
Therapeutic area(s): Diseases [C] - Musculoskeletal Diseases [C05]
Gender: Female, Male. Age: 18-64 years. Enrolment: 80.
Status: Ended. Start date (EU): 2023-09-14. End date (EU): 2023-12-13. Decision date: 2023-06-20. Results received: Yes. Last updated: 2023-10-16.

Condition(s): patch adhesion trial with healthy subjects, therapeutical indication not studied
Product: Esflurbiprofen hydrogel patch 165 mg (EFHP)

Primary endpoint: Assessment of EFTS adhesion 5 min prior to removal by the adhesion assessment by site staff with EFTS marked by site staff
Endpoint(s): Assessment of EFTS adhesion before bedtime (-1h), after waking up (+1h), and 5 min prior to removal by the visual adhesion assessment by subject, Assessment of EFTS adhesion before bedtime (-1h), after waking up (+1h), and 5 min prior to removal by site staff with EFTS marked by subject

Source: https://euclinicaltrials.eu/ctis-public/view/2023-503609-12-00